EU clinical trial 2024-519292-26-00: A Phase 2, Randomised, Double-masked, Placebo-controlled, Parallel-group, Multi-centre Study to Evaluate K1-70 in Patients with Active Thyroid Eye Disease in Europe
Protocol code: AV7-K1-70-IV-002
Sponsor: Av7 Limited (Pharmaceutical company). Phase: Therapeutic exploratory (Phase II). Countries: Spain (ongoing, recruiting), Italy (authorised, recruiting).
Therapeutic area(s): Diseases [C] - Eye Diseases [C11]; Diseases [C] - Immune System Diseases [C20]
Gender: Female, Male. Age: 18-64 years, 65+ years. Enrolment: 50.
Start date (EU): 2026-05-28. Decision date: 2026-02-05. Results received: No. Last updated: 2026-02-16.
Decision dates by country: IT: 2026-02-16, ES: 2026-02-05

Condition(s): Graves’ disease and active thyroid eye disease
Product: K1-70, Placebo to K1-70™

Primary endpoint: Exophthalmos improvement rate at Week 24* *The proportion (%) of subjects who achieve at least a 2-mm decrease in exophthalmos of the study eye from baseline and have no worsening in exophthalmos (defined as an increase of at least 2 mm) in the fellow eye.
Endpoint(s): Change from baseline in the ratio of signal intensity in the extraocular muscles shown by MRI. Change from baseline in the GO-QOL score Change from baseline in the CAS. Change from baseline in exophthalmos measurement . Change from baseline in diplopia grade (Bahn-Gorman scale) (diplopia improvement rate) Change from baseline in retrobulbar volume shown by MRI, Safety, determined by: a) AEs b) Vital sign measurements c) 12-lead ECG measurements d) Laboratory test results e) Physical examination results f) Eye examination results Changes in levels of TSH, thyroid hormones (FT4 and FT3), TSH receptor autoantibodies and stimulating TSH receptor autoantibodies Change over time in blood concentrations of K1-70 Change over time in blood concentrations of Anti-drug antibodies

Source: https://euclinicaltrials.eu/ctis-public/view/2024-519292-26-00